EU clinical trial 2025-524062-16-00: A Phase 3 Multicenter, Open-label Study to Assess the Long-term Safety and Tolerability of KarXT in Adolescents (13 to 17 years of age) with Schizophrenia and KarXT+KarX-EC in Children and Adolescents (5 to 17 years of age) with Irritability Associated with Autism Spectrum Disorder
Protocol code: CN0120021
Sponsor: Bristol-Myers Squibb Services Unlimited Company (Pharmaceutical company). Phase: Therapeutic confirmatory (Phase III). Countries: Romania (authorised, recruitment pending).
Therapeutic area(s): Diseases [C] - Nervous System Diseases [C10]; Psychiatry and Psychology [F] - Mental Disorders [F03]
Gender: Female, Male. Age: 0-17 years. Enrolment: 40.
Status: Authorised, recruitment pending. Decision date: 2026-05-29. Results received: No. Last updated: 2026-05-29.

Condition(s): Schizophrenia and Autism Spectrum Disorder (ASD)
Product: KarXT, KarX-EC, KarXT, KarXT, KarX-EC, KarX-EC, KarXT, KarXT, KarX-EC, KarXT, KarXT

Primary endpoint: Occurrence of treatment-emergent adverse events (TEAEs), adverse events of special interest (AESIs), and serious adverse events (SAEs) during the treatment and safety follow-up periods.
Endpoint(s): Occurrence of procholinergic and anticholinergic symptoms during the treatment period., Suicidal ideation and behavior assessed using the Columbia Suicide Severity Rating Scale (C-SSRS) during the treatment and safety follow-up periods., Change from baseline (CFB) on the Simpson-Angus Scale (SAS), Barnes-Akathisia Rating Scale (BARS), and Abnormal Involuntary Movement Scale (AIMS) by visit during the treatment period.

Source: https://euclinicaltrials.eu/ctis-public/view/2025-524062-16-00